EU clinical trial 2026-525324-26-00: Long-term outcomes and safety of repeated rituximab treatment in psychotic disorders – RITS-LONG
Protocol code: RITS-LONG
Sponsor: Region Oerebro Laen (Hospital/Clinic/Other health care facility). Phase: Therapeutic exploratory (Phase II). Countries: Sweden (authorised, recruitment pending).
Therapeutic area(s): Psychiatry and Psychology [F] - Mental Disorders [F03]
Gender: Female, Male. Age: 18-64 years. Enrolment: 122.
Status: Authorised, recruitment pending. Decision date: 2026-06-05. Results received: No. Last updated: 2026-06-05.

Condition(s): Schizophrenia spectrum disorder (SSD)
Product: RITUXIMAB

Primary endpoint: The proportion of participants rated as more than minimally improved (CGI-I ≤ 2.5), assessed 4 months (±1 month) after two infusions of rituximab in the RITS-LONG trial. Improvement is evaluated relative to baseline symptom severity and functional status recorded in the RITS-LONG study.The results are compared to the historical placebo response estimated from the preceding RCT-Rits trial and presented separately by initial treatment group in the RCT-Rits (placebo or rituximab)
Endpoint(s): Clinical improvement (CGI-I): Proportion of participants rated as more than minimally improved according to Clinical Global Impression – Improvement, CGI-I (Guy, 1976) score of ≤ 2.5 at Time point 1 and Time point 2., Severity of illness (CGI-S): Clinician-rated Clinical Global Impression – Severity (CGI-S) score, Personal and Social Performance Scale (PSP): Clinician-rated assessment of overall functioning and disability (PSP score), Self-rated health (VAS-Health): Patient’s self-rated general well-being using the Visual Analogue Scale (VAS-Health)., Self-Assessment of Negative Symptoms (SNS) and Level 1 Cross-cutting symptom measure of global symptom severity (CCSM): Patient-reported negative symptom severity (SNS total score) and comorbid psychiatric symptoms (CCSM), Informant-rated improvement (I-CGI-I): Informant’s (e.g. significant other or close relative) rating of patient improvement using the Informant-CGI-I at Time point 1 and Time point 2, compared with placebo in RCT-Rits. CGI-I was not originally developed for informant assessment but used as such in the RCT-Rits trial., Positive and Negative Syndrome Scale (PANSS): A semi structured clinical interview for assessing symptoms and severity of psychotic disorders (Kay et al. 1987). PANSS will be assessed at Time point 1 and Time point 2., Biomarkers: Changes in relevant peripheral biomarkers., Patient and significant-other satisfaction and experience: Quantitative and qualitative assessments of satisfaction and experiences related to rituximab treatment, collected at Time point 1.

Source: https://euclinicaltrials.eu/ctis-public/view/2026-525324-26-00